EU clinical trial 2024-510696-38-00: ISIS 678354-CS5: A Randomized, Double-Blind, Placebo-Controlled, Phase 3 Study of ISIS 678354 Administered Subcutaneously to Patients with Severe Hypertriglyceridemia.
Protocol code: ISIS 678354-CS5
Sponsor: Ionis Pharmaceuticals Inc. (Pharmaceutical company). Phase: Therapeutic confirmatory (Phase III). Countries: Finland (ended), Germany (ended), Poland (ended), Sweden (ended), Slovakia (ended), Hungary (ended), Czechia (ended), Denmark (ended), Portugal (ended), Norway (ended), Netherlands (ended), Spain (ended), Bulgaria (ended), Italy (ended), France (ended).
Therapeutic area(s): Diseases [C] - Congenital, Hereditary, and Neonatal Diseases and Abnormalities [C16]
Gender: Female, Male. Age: 18-64 years, 65+ years. Enrolment: 368.
Start date (EU): 2022-03-08. End date: 2025-07-08. Decision date: 2024-06-04. Results received: Yes. Last updated: 2025-06-30.
Decision dates by country: FI: 2024-06-06, FR: 2024-07-05, PT: 2024-06-12, ES: 2024-06-07, SE: 2024-06-05, BG: 2024-06-19, DK: 2024-06-10, DE: 2024-06-06, IT: 2024-06-19, SK: 2024-06-04, NL: 2024-06-04, NO: 2024-06-06, PL: 2024-06-07, CZ: 2024-06-06, HU: 2024-06-04

Condition(s): Severe Hypertriglyceridemia.
Product: Placebo injection, 0.8 ml is a sterile, preservative-free, parenteral solution of sodium chloride and riboflavin in water for injection (wfi) intended for subcutaneous injection, ISIS 678354

Primary endpoint: Percent Change from Baseline in Fasting TG at 6 Months (Average of Weeks 25 and 27) Compared to Placebo.
Endpoint(s): Percent Change from Baseline in Fasting TG Compared to Placebo [Time Frame: Baseline and Month 12], Percent Change from Baseline in Fasting Apolipoprotein C-III (ApoC-III), Remnant Cholesterol and Non-High-Density Lipoprotein-Cholesterol (Non-HDL-C) Compared to Placebo (Time Frame: Baseline, Month 6 and 12], Proportion of Patients who Achieve Fasting TG <500 mg/dL (5.65 mmol/L) Compared to Placebo [Time Frame: Month 12], Proportion of Patients Who Achieve Fasting TG < 880 mg/dL (10 mmol/L) Compared to Placebo in the Subgroup of Patients with Baseline TG ≥ 880 mg/dL [Time Frame: Month 12], Adjudicated Acute Pancreatitis Event Rate During the Treatment Period Compared to Placebo [Time Frame: Week 1 through Week 53], Absolute Change in Hepatic Fat Fraction (HFF) Between Olezarsen Treatment Group and Placebo

Source: https://euclinicaltrials.eu/ctis-public/view/2024-510696-38-00